EU clinical trial 2023-508863-59-01: Perioperative Therapy with Durvalumab Plus Tremelimumab for Patients with Resectable Hepatocellular Carcinoma (HCC) - A Phase II Trial (NEOTOMA)
Sponsor: University Health Network (Hospital/Clinic/Other health care facility). Phase: Therapeutic exploratory (Phase II). Countries: Spain (ongoing, recruiting), Italy (authorised, recruitment pending).
Therapeutic area(s): Diseases [C] - Digestive System Diseases [C06]; Diseases [C] - Neoplasms [C04]
Gender: Female, Male. Age: 18-64 years, 65+ years. Enrolment: 10.
Start date (EU): 2026-06-17. Decision date: 2024-11-19. Results received: No. Last updated: 2025-11-17.
Decision dates by country: IT: 2024-11-25, ES: 2024-11-19

Condition(s): Resectable Hepatocellular Carcinoma
Product: TREMELIMUMAB, DURVALUMAB

Primary endpoint: The number of ≥ grade 3 adverse events (AEs) or immune related adverse events that leads to treatment cessation
Endpoint(s): The number of patients who experience a surgical delay due to treatment related adverse events (TRAEs), According to RECIST v1.1 and mRECIST: Objective response rate (ORR), % Viable tumour remaining, Number of resections with negative margins Exploratory Recurrence free survival using RECIST 1.1, Overall survival, Planned analyses include • CITEseq. (N=5) • Multiparameter Flow Cytometry. • T cell receptor sequencing to define T-cell clonal distribution and functional specificity for mutant tumour antigens (n=5). • Multiplex immunohistochemical analysis (IHC) of immune cell populations., Blood samples will be banked for: • TCR sequencing; • Blood immunophenotyping; • Additional blood will be banked for future analyses including cfDNA quantification, Stool will be collected and banked for future correlative analyses

Source: https://euclinicaltrials.eu/ctis-public/view/2023-508863-59-01